EU clinical trial 2025-521744-37-00: Multi-centre, double-blind, placebo-controlled, randomised trial to prove the efficacy and safety of Silexan® (WS®1265) in patients with a major depressive episode of mild to moderate severity
Protocol code: D.01.01.3.06
Sponsor: Dr. Willmar Schwabe GmbH & Co. KG (Pharmaceutical company). Phase: Therapeutic confirmatory (Phase III). Countries: Germany (ongoing, recruiting), Austria (ongoing, recruiting).
Therapeutic area(s): Psychiatry and Psychology [F] - Mental Disorders [F03]
Gender: Female, Male. Age: 18-64 years, 65+ years. Enrolment: 500.
Status: Ongoing, recruiting. Start date (EU): 2025-11-17. Decision date: 2025-10-06. Results received: No. Last updated: 2026-06-05.
Decision dates by country: AT: 2025-10-13, DE: 2025-10-06

Condition(s): Mild to moderate major depressive disorder
Product: Silexan 80 mg, Placebo to Silexan 80 mg

Primary endpoint: The change in MADRS total score between Baseline and Week 8.
Endpoint(s): Efficacy endpoint: • Changes from Baseline in Clinical Global Impressions (CGI) (Item 1), Patient Health Questionnaire-9(PHQ-9) total score, Sheehan Disability Scale (SDS) total score at Week 8, Efficacy endpoint: • CGI (Item 2) at Week 8, Efficacy endpoint: • At least 50% reduction of MADRS total score between Baseline and Week 8 (responder), Efficacy endpoint: • MADRS total score < 10 at Week 8 (remitter)., Safety endpoint:• Frequency of participants with at least one Adverse Event (AE),Adverse Drug Reaction (ADR), serious AE; number, type, severity and seriousness of AEs, and their relationship to the Investigational Medicinal Product (IMP); frequency of participants with AEs leading to withdrawal, Safety endpoint:• Evaluation of safety assessments (physical examination, vital signs, 12-lead electrocardiography (ECG), laboratory evaluation, concomitant medication, non-medicinal psychiatric treatment), Safety endpoint:• Risk of suicide

Source: https://euclinicaltrials.eu/ctis-public/view/2025-521744-37-00